EU clinical trial 2024-517420-20-00: SerCaBot-2302 - Serratus Plane Block (SPB) versus Capsaicin versus Botulinum toxin type A for the chronic neuropathic pain of post-mastectomy syndrome
Protocol code: SerCaBot-2302
Sponsor: Centre Oscar Lambret (Pharmaceutical company). Phase: Therapeutic exploratory (Phase II). Countries: France (authorised, recruiting).
Therapeutic area(s): Diseases [C] - Neoplasms [C04]
Gender: Female. Age: 18-64 years, 65+ years. Enrolment: 123.
Status: Authorised, recruiting. Start date (EU): 2025-06-10. Decision date: 2025-01-22. Results received: No. Last updated: 2025-06-06.

Condition(s): Chronic neuropathic pain of post-mastectomy syndrome
Product: OXYCODONE, TRAMADOL, ROPIVACAINE, MORPHINE, CLONIDINE, CAPSAICIN, PARACETAMOL, NEFOPAM, BOTULINUM TOXIN, MIDAZOLAM, PROPOFOL

Primary endpoint: The primary endpoint assesses pain through self-assessment using the Numerical Pain Scale (NPS), rated from 0 to 10, at 8 weeks after treatment or 9 weeks after randomization. If treatment fails before 8 weeks, assessment may occur earlier. Self-assessment is preferred as it reflects the individual's perception of treatment efficacy. If local treatment is interrupted, the baseline NPS measurement will be used for the primary analysis.
Endpoint(s): Success in pain control at 8 weeks defined by a reduction in pain of 3 points or more, versus failure in other cases, Evolution of the NPS after treatment, self-assessed by the patient according to the same modalities as for the primary endpoint, at 1, 2, 4, 6, 8, and 24 weeks after treatment (and at 13, 14, 16, and 18 weeks in case of treatment repetition at 12 weeks); data collection is planned during pain management consultations and between these consultations through remote evaluations, Evolution of the neuropathic component, self-assessed via the NPSI questionnaire, at 1, 2, 4, 6, 8, and 24 weeks after treatment (and at 13, 14, 16, and 18 weeks in case of treatment repetition at 12 weeks), Early failure of local analgesic treatment, defined by: - Treatment failure: interruption of the procedure (due to intolerance in the Capsaicin and Botox-A groups, and due to technical problems in the SPB group); - Failure in pain control assessed 7 and 14 days after the procedure (or earlier in case of a call, minimum 72 hours), defined by no improvement in the NPS leading to the need to introduce a new systemic antineuropathic treatment, or the need to resort to TENS, Modification or introduction of a new systemic analgesic treatment (gabapentinoid, tricyclic antidepressant, IRSNA, opioids) or TENS, Adverse events possibly related to the treatment performed (capsaicin, botulinum toxin type A, or SPB block), during the local procedure and afterwards, graded according to the NCI-CTCAE v5.0 scale. Pain leading to cessation of the procedure as well as a hematoma or pneumothorax of grade 2 or more will be considered severe adverse events, HADS scale, measured at baseline and during visits at 8 and 24 weeks, Quality of Life scale (Health Related QOL: SF-12) measured at baseline and during visits at 8 and 24 weeks, Patient General Impression of Change (PGIC) self-assessment scale from 1 (no change or worse) to 7 (considerable improvement making a clear difference), measured during visits at 8 and 24 weeks

Source: https://euclinicaltrials.eu/ctis-public/view/2024-517420-20-00